EU clinical trial 2023-509644-10-00: A Phase 1b/2, Open-label, Randomized Study of Vudalimab in Combination With Chemotherapy or Pembrolizumab in Combination With Chemotherapy as First-line Treatment in Patients With Advanced Non-small Cell Lung Cancer
Protocol code: XmAb717-06
Sponsor: Xencor Inc. (Pharmaceutical company). Phase: Phase I and Phase II (Integrated)- Other. Countries: Netherlands (ended), Belgium (ended), Spain (ended), Greece (ended), Portugal (ended), Romania (ended), Poland (ended).
Therapeutic area(s): Diseases [C] - Neoplasms [C04]
Gender: Female, Male. Age: 18-64 years, 65+ years. Enrolment: 116.
Status: Ended. Start date (EU): 2024-06-27. End date (EU): 2025-12-29. End date: 2025-12-30. Decision date: 2024-05-21. Results received: No. Last updated: 2025-11-17.
Decision dates by country: GR: 2024-09-09, NL: 2024-05-21, PL: 2024-09-06, BE: 2024-05-21, RO: 2024-08-05, ES: 2024-05-24, PT: 2024-07-16

Condition(s): Advanced Non-small Cell Lung Cancer
Product: Pemetrexed Ribosepharm 25 mg/ml Konzentrat zur Herstellung einer Infusionslösung, Vudalimab, Carboplatin Hikma 10 mg/ml Konzentrat zur Herstellung einer Infusionslösung, KEYTRUDA 25 mg/mL concentrate for solution for infusion

Primary endpoint: Part 1 Primary - Incidence of TEAEs Treatment-related adverse events leading to discontinuation of treatment, Part 2 Primary - PFS (time from randomization to disease progression per RECIST 1.1 or death, whichever comes first)
Endpoint(s): Part 1 Secondary - ORR, as determined by the Investigator (per RECIST 1.1), and DOR. Part 1 Secondary - Changes in ctDNA over time. Part 1 Secondary - Cmax, Ctrough, and other key exposure parameters., Part 2 Secondary - ORR (RECIST 1.1), DCR and DOR. Part 2 Secondary - OS (time from randomization to death from any cause). Part 2 Secondary - Incidence of TEAEs. Part 2 Secondary - Changes in ctDNA over time. Part 2 Secondary - Cmax, Ctrough and other key exposure parameters.

Source: https://euclinicaltrials.eu/ctis-public/view/2023-509644-10-00